EU clinical trial 2024-513859-33-00: An Open-label, Multinational, Multicenter, Intravenous Infusion Study of the Efficacy, Safety, Pharmacokinetics, and Pharmacodynamics of Avalglucosidase Alfa in Treatment-naïve Pediatric Participants with Infantile-Onset Pompe Disease (IOPD)
Protocol code: EFC14462
Sponsor: Sanofi-Aventis Recherche & Developpement (Pharmaceutical company). Phase: Therapeutic confirmatory (Phase III). Countries: Spain (ended), Netherlands (ended), Germany (ended), Belgium (ended), Italy (ended).
Therapeutic area(s): Diseases [C] - Congenital, Hereditary, and Neonatal Diseases and Abnormalities [C16]
Gender: Female, Male. Age: 0-17 years. Enrolment: 8.
Status: Ended. Start date (EU): 2022-08-26. End date (EU): 2026-03-27. Decision date: 2024-07-09. Results received: No. Last updated: 2025-04-08.
Decision dates by country: IT: 2024-07-22, DE: 2024-07-15, NL: 2024-07-09, BE: 2024-07-12, ES: 2024-07-09

Condition(s): Glycogen storage disease type II
Product: Nexviadyme 100 mg powder for concentrate for solution for infusion, Nexviadyme 100 mg powder for concentrate for solution for infusion, avalglucosidase alfa, Nexviadyme 100 mg powder for concentrate for solution for infusion, Nexviadyme 100 mg powder for concentrate for solution for infusion

Primary endpoint: Proportion of participants who are alive and free of invasive ventilation at Week 52
Endpoint(s): Proportion of participants who are alive and free of invasive ventilation at 12 and 18 months of age, Proportion of participants who are alive at Week 52, Proportion of participants who are alive at 12 and 18 months of age, Proportion of participants who are free of ventilator use (invasive and non-invasive separate and combined) at Week 52, Proportion of participants who are free of supplemental oxygen use at Week 52, Change from baseline to Week 52 in left ventricular mass (LVM)-Z score, Change from baseline to Week 52 in Alberta Infant Motor Scale (AIMS) score, Change from baseline to Week 52 in body length Z-scores, Change from baseline to Week 52 in body weight Z-scores, Change from baseline to Week 52 in head circumference Z-scores, Change from baseline to Week 52 in body length percentiles, Change from baseline to Week 52 in body weight percentiles, Change from baseline to Week 52 in head circumference percentiles, Change from baseline to Week 52 in urinary Hex4, Number of participants experiencing at least 1 treatment-emergent adverse events (TEAE), including infusion associated reactions (IAR), Number of participants with abnormalities in physical examinations, Number of participants with potentially clinically significant abnormality (PCSA) in clinical laboratory results, Number of participants with PCSA in vital signs measurements, Number of participants with PCSA in 12-lead electrocardiogram (ECG), Incidence of treatment-emergent anti-drug antibodies (ADA), Plasma concentration of avalglucosidase alfa

Source: https://euclinicaltrials.eu/ctis-public/view/2024-513859-33-00